EU clinical trial 2024-516201-23-00: A multicentre phase II, open-label, non-randomized study evaluating Platinum-Pemetrexed-Atezolizumab ( Bevacizumab) for patients with stage IIIB/IV non-squamous non-small cell lung cancer with EGFR mutations, ALK rearrangement or ROS1 fusion progressing after Targeted therapies
Protocol code: GFPC 06-2018
Sponsor: Centre Francois Baclesse (Hospital/Clinic/Other health care facility). Phase: Therapeutic exploratory (Phase II). Countries: France (ended).
Therapeutic area(s): Diseases [C] - Neoplasms [C04]
Gender: Female, Male. Age: 18-64 years, 65+ years. Enrolment: 150.
Status: Ended. Start date (EU): 2019-08-26. End date (EU): 2025-04-09. Decision date: 2024-11-05. Results received: Yes. Last updated: 2024-11-05.

Condition(s): Lung Cancer, NSCLC
Product: Cisplatin 1 mg/ml Concentrate for Solution for Infusion, PEMETREXED, BEVACIZUMAB, CARBOPLATINE MEDAC 10 mg/mL, solution à diluer pour perfusion, Tecentriq 1 200 mg concentrate for solution for infusion

Primary endpoint: Objective response rate (ORR), defined as the proportion of patients who achieved an objective response after 4 cycles of induction (or before progression). Objective response will be considered in case of radiologically confirmed complete (CR) or partial response (PR) according to RECIST v1.1 criteria (Response Evaluation Criteria in Solid Tumors version 1.1) assessed by masked, independent central review.
Endpoint(s): ● Progression-free survival, defined as the time relapsed between inclusion and disease progression (according to RECIST v1.1 criteria as assessed by the investigator) or death from any cause, whichever occurs first, ● Duration of response assessed in patients who had an objective response as determined by the investigator using RECIST v1.1 and defined as the time interval from the date of the first occurrence of a CR or PR (whichever status is recorded first) until the first date that progressive disease or death is documented, whichever occurs first, ● Time to deterioration in lung-related symptoms, defined as the time from inclusion to the time the patient’s score on the EORTC QLQ C30 or QLQ-LC13 shows a ≥10-point increase above baseline in each of the following EORTC-transformed scores for cough, dyspnea (single item), dyspnea (multi-item subscale) and chest pain., ● Objective response rate according to immune (i)RECIST criteria defined similarly as ORR, with the exception that immune RECIST criteria 2017 are used instead of RECIST v 1.1, ● Overall survival, defined as the time between the date of inclusion and death from any cause, ● Toxicities occurring during either the induction or maintenance treatment in terms of kind, grade, time of onset, reversibility, according to NCI-CTCAE v5.0 criteria

Source: https://euclinicaltrials.eu/ctis-public/view/2024-516201-23-00